EU clinical trial 2024-510579-40-00: FaR-RMS: An overarching study for children and adults with Frontline and Relapsed RhabdoMyoSarcoma
Protocol code: RG_17-247
Sponsor: The University Of Birmingham (Educational Institution). Phase: Phase I and Phase II (Integrated)- Other. Countries: Netherlands (ongoing, recruiting), Portugal (authorised, recruitment pending), Italy (ongoing, recruiting), Sweden (ongoing, recruiting), Norway (ongoing, recruiting), Austria (ongoing, recruiting), Slovenia (ongoing, recruiting), Ireland (ongoing, recruiting), Finland (authorised, recruitment pending), Spain (ongoing, recruiting), France (ongoing, recruiting), Denmark (ongoing, recruiting), Greece (ongoing, recruiting), Belgium (ongoing, recruiting), Germany (ongoing, recruiting), Czechia (ongoing, recruiting).
Therapeutic area(s): Diseases [C] - Neoplasms [C04]
Gender: Female, Male. Age: 0-17 years, 18-64 years, 65+ years. Enrolment: 1185.
Start date (EU): 2020-10-07. Decision date: 2024-11-15. Results received: No. Last updated: 2026-07-01.
Decision dates by country: AT: 2024-11-19, BE: 2024-11-18, CZ: 2024-11-15, DK: 2024-11-15, GR: 2024-12-09, IE: 2024-11-15, SI: 2024-11-18, ES: 2024-11-18, SE: 2024-11-18, NL: 2024-11-15, FR: 2024-11-15, FI: 2024-11-20, IT: 2024-11-20, PT: 2024-11-18, NO: 2024-11-18, DE: 2024-11-18

Condition(s): Rhabdoyosarcoma
Product: TEMOZOLOMIDE, VINORELBINE TARTRATE, DACTINOMYCIN, IFOSFAMIDE, CYCLOPHOSPHAMIDE, Regorafenib_PIP, VINORELBINE TARTRATE, IRINOTECAN, Regorafenib_PIP, TEMOZOLOMIDE, CYCLOPHOSPHAMIDE, VINCRISTINE SULFATE, DOXORUBICIN, REGORAFENIB, TEMOZOLOMIDE, CYCLOPHOSPHAMIDE, TEMOZOLOMIDE, TEMOZOLOMIDE, TEMOZOLOMIDE

Primary endpoint: Recommended Phase 2 Dose (RP2D) - Phase 1b, Event Free Survival for randomisations CT1a, CT1b, CT2, RT2 and CT3, Local failure free survival for randomisations RT1a, RT1b and RT1c
Endpoint(s): Maximum Tolerated Dose for registration phase 1b, Dose Limiting Toxicity for registration phase 1b, Overall Survival for all patients, randomisations CT1a, CT1b, CT2, CT3, RT1a, RT1b, RT1c and also RT, Event Free Survival for all patients, randomisations RT1a, RT1b, RT1c and also the PET sub-study, Loco-regional failure-free survival for randomisations RT1a, RT1b, RT1c and RT2, Local failure free survival for the PET sub-study, Response for registration phase 1b and also randomisations CT1a, CT1b, and CT3, Best Response for randomisation CT3, Duration of response for randomisation CT3, Toxicity for registration phase 1b and also randomisations CT1a, CT1b, and CT3, Acute post-radiotherapy complications for randomisations RT1a, RT1b, RT1c and RT2, Late complications for randomisations RT1a, RT1b and RT1c, Acute post-operative complications for randomisations RT1a and RT1b, Wound complications for randomisations RT1a and RT1b, Health Related Quality of Life for randomisations RT1a and RT2, PET response for the PET sub-study

Source: https://euclinicaltrials.eu/ctis-public/view/2024-510579-40-00